EU clinical trial 2024-518378-14-00: A Double-Masked, Randomized, Placebo-Controlled, Paired Eye Study to Evaluate the Efficacy, Safety and Tolerability of Sepofarsen in Subjects with Leber Congenital Amaurosis (LCA) due to the c.2991+1655A>G (p.Cys998X) Mutation in the CEP290 Gene
Protocol code: SB-110-007
Sponsor: Laboratoires Thea (Pharmaceutical company). Phase: Therapeutic confirmatory (Phase III). Countries: Netherlands (ongoing, recruiting), Belgium (ongoing, recruiting), France (ongoing, recruiting), Germany (ongoing, recruiting), Spain (ongoing, recruiting).
Therapeutic area(s): Diseases [C] - Eye Diseases [C11]
Gender: Female, Male. Age: 0-17 years, 18-64 years, 65+ years. Enrolment: 19.
Status: Ongoing, recruiting. Start date (EU): 2025-07-11. Decision date: 2025-04-01. Results received: No. Last updated: 2026-05-05.
Decision dates by country: FR: 2025-04-07, BE: 2025-04-07, DE: 2025-04-01, NL: 2025-04-15, ES: 2026-05-04

Condition(s): Leber congenital amaurosis (LCA)
Product: Placebo

Primary endpoint: Change from baseline in best-corrected visual acuity (BCVA) based on the Freiburg Acuity and Contrast Test (FrACT) between treatment eyes (TEs) and placebo control eyes (PCEs) at 12 months.
Endpoint(s): Change from baseline in low luminance visual acuity (LLVA) based on FrACT between TEs and PCEs at 12 months., Change from baseline in retinal sensitivity as measured by dark-adapted full-field stimulus test (FST) between TEs and PCEs at 12 months., Eye-specific Patient Global Impression of Change (PGI-C) between TEs and PCEs at 12 months., Change from baseline in contrast sensitivity (CS) between TEs and PCEs based on quick contrast sensitivity function (qCSF) at 12 months., Incidence and severity of ocular and non-ocular adverse events (AEs).

Source: https://euclinicaltrials.eu/ctis-public/view/2024-518378-14-00